EU clinical trial 2023-509943-28-00: A Phase III, Double-blind, Randomised, Placebo-Controlled, International Study to assess the Efficacy and Safety of Adjuvant Osimertinib versus Placebo in Participants with EGFR mutation positive Stage IA2-IA3 Non-small Cell Lung Cancer, following Complete Tumour Resection (ADAURA2)
Protocol code: D516FC00001(ADAURA2)
Sponsor: AstraZeneca AB (Pharmaceutical company). Phase: Therapeutic confirmatory (Phase III). Countries: Germany (ended), Spain (ongoing, recruitment ended), Romania (ended), Italy (ongoing, recruitment ended), Poland (ongoing, recruitment ended).
Therapeutic area(s): Diseases [C] - Neoplasms [C04]
Gender: Female, Male. Age: 18-64 years, 65+ years. Enrolment: 21.
Start date (EU): 2022-05-18. Decision date: 2024-09-25. Results received: No. Last updated: 2026-08-05.
Decision dates by country: DE: 2024-09-25, RO: 2024-09-30, ES: 2024-09-25, IT: 2024-10-07, PL: 2024-10-16

Condition(s): Stage IA2-IA3 non-small cell lung carcinoma, with EGFR mutation type (Ex19del, L858R), following complete tumour resection.
Product: TAGRISSO 40 mg film-coated tablets, TAGRISSO 80 mg film-coated tablets, Placebo

Primary endpoint: Disease free survival (DFS) in the high-risk stratum by investigators' assessment.
Endpoint(s): Disease free survival (DFS) in the overall population by investigator's assessment., Disease free survival (DFS) in both the high-risk stratum and overall population., Overall survival (OS) in participants in both the high-risk stratum and overall population., Impact of osimertinib versus placebo on physical functioning in both the high-risk stratum and overall population., Effectiveness of osimertinib versus placebo by assessment of central nervous system disease free survival (DFS) in both the high-risk stratum and the overall population., Characterise the pharmacokinetics of osimertinib and its metabolites (AZ13575104 [AZ5104]) in the overall population., Safety and tolerability profile of osimertinib versus placebo in the overall population.

Source: https://euclinicaltrials.eu/ctis-public/view/2023-509943-28-00